EU clinical trial 2024-510891-20-00: Monitoring the AD effects of ketamine in MDD patients
Protocol code: CHDR2356
Sponsor: Centre for Human Drug Research (Laboratory/Research/Testing facility). Phase: Human Pharmacology (Phase I)- Other. Countries: Netherlands (ended).
Therapeutic area(s): Psychiatry and Psychology [F] - Mental Disorders [F03]
Gender: Female, Male. Age: 18-64 years, 65+ years. Enrolment: 12.
Status: Ended. End date (EU): 2024-12-03. Decision date: 2024-05-17. Results received: No. Last updated: 2024-07-19.

Condition(s): Major depressive disorder

Source: https://euclinicaltrials.eu/ctis-public/view/2024-510891-20-00